EU clinical trial 2023-505673-32-00: A Phase 3, Randomized, Double-blinded, Placebo-controlled, Multicenter Study to Evaluate Efficacy and Safety of ALXN1850 (Recombinant Alkaline Phosphatase) Administered Subcutaneously in Adolescent (12 to < 18 years of age) and Adult Participants with Hypophosphatasia Who Have Not Previously Been Treated with Asfotase Alfa (Hickory)
Protocol code: ALXN1850-HPP-301
Sponsor: Alexion Pharmaceuticals Inc. (Pharmaceutical company). Phase: Therapeutic confirmatory (Phase III). Countries: Poland (ongoing, recruitment ended), Austria (ongoing, recruitment ended), Germany (ongoing, recruitment ended), Belgium (ended), Italy (ongoing, recruitment ended), France (ongoing, recruitment ended), Spain (ongoing, recruitment ended), Slovakia (ended).
Therapeutic area(s): Diseases [C] - Congenital, Hereditary, and Neonatal Diseases and Abnormalities [C16]; Diseases [C] - Nutritional and Metabolic Diseases [C18]
Gender: Female, Male. Age: 0-17 years, 18-64 years, 65+ years. Enrolment: 34.
Start date (EU): 2024-08-05. Decision date: 2024-03-27. Results received: No. Last updated: 2025-07-02.
Decision dates by country: AT: 2024-04-01, BE: 2024-03-28, SK: 2024-03-27, ES: 2024-04-01, FR: 2024-06-18, PL: 2024-04-02, IT: 2024-03-27, DE: 2024-03-27

Condition(s): Hypophosphatasia
Product: ALXN1850 placebo product, ALXN1850

Primary endpoint: Change from baseline in 6MWT at the end of the Randomized Evaluation Period (Day 169)
Endpoint(s): Change from baseline in 30-second STS test at the end of the Randomized Evaluation Period (Day 169), Change from baseline in LEFS at the end of the Randomized Evaluation Period (Day 169), Change from baseline in BPI-SF pain severity score at the end of the Randomized Evaluation Period (Day 169), Change from baseline in FACIT-Fatigue score at the end of the Randomized Evaluation Period (Day 169), Change from baseline in Timed Up-and-Go (TUG) at the end of the Randomized Evaluation Period (Day 169), Change from baseline in % Predicted 6MWT at the end of the Randomized Evaluation Period (Day 169), RGI-C Score at the end of the Randomized Evaluation Period (Day 169), RGI-C responder at the end of the Randomized Evaluation Period (Day 169), Change from baseline in RSS at the end of the Randomized Evaluation Period (Day 169), Change from baseline at the end of the Randomized Evaluation Period (Day 169) in: - EuroQoL 5 Dimensions 5 Level (EQ-5D-5L) scale - SF-36v2 PCS score, Change from baseline in BPI-SF pain interference score at the end of the Randomized Evaluation Period (Day 169), Change from baseline at the end of the Randomized Evaluation Period (Day 169) in: - PODCI Adolescent – Self-reported - APPT score - Pediatric FACIT-Fatigue score, TSQM-9 score at the end of the Randomized Evaluation Period (Day 169), Incidence of TEAEs, TESAEs, AESIs, and AEs leading to study intervention discontinuation or interruption, Plasma ALXN1850 Ctrough over time through the end of the Randomized Evaluation Period (Day 169), Plasma ALXN1850 PK parameters in adolescent participants during the Randomized Evaluation Period, Observed, change from baseline, and percent change from baseline in plasma concentration of PPi, PLP, PA, and PLP/PL ratio over time through the end of the Randomized Evaluation Period (Day 169), ADA incidence, ADA response categories, and ADA titer, as well as NAb incidence and NAb titer

Source: https://euclinicaltrials.eu/ctis-public/view/2023-505673-32-00